EU clinical trial 2024-516639-28-00: Efficacy of early Argipressin (arginine vasopressin) in the management of intensive care patients with norepinephrine-refractory vasoplegic shock: a multicentric randomized, double-blind placebo-controlled superiority trial : Vaso²R
Protocol code: Vaso²R
Sponsor: Centre Hospitalier Universitaire De Dijon (Hospital/Clinic/Other health care facility). Phase: Therapeutic confirmatory (Phase III). Countries: France (ongoing, recruiting).
Therapeutic area(s): Analytical, Diagnostic and Therapeutic Techniques and Equipment [E] - Anesthesia and Analgesia [E03]
Gender: Female, Male. Age: 18-64 years, 65+ years. Enrolment: 390.
Status: Ongoing, recruiting. Start date (EU): 2026-03-27. Decision date: 2025-06-27. Results received: No. Last updated: 2026-01-14.

Condition(s): norepinephrine-refractory vasoplegic shock
Product: REVERPLEG 40 U.I./2 mL, solution à diluer pour perfusion, CHLORURE DE SODIUM 0,9 % VIAFLO, solution pour perfusion

Primary endpoint: Composite score including 3 criterions ordered from most to the least important: -mortality at D30 -use of renal replacement therapy (RRT) within 30 days post-inclusion -persistance of vasopressor use within 15 days post-inclusion. The score is calculated by comparing each patient from one group to all patients from the other group in the concerned strata (stratified win-ratio analysis).
Endpoint(s): Efficacy objectives: comparison between experimental group and placebo group: 1.number of all cause deaths in ICU, at D30 and D90, Efficacy objectives: comparison between experimental group and placebo group: 2.renal failure (score ≥ 2 on the kidney disease improving global outcome (KDIGO) classification) at D30 and D90, Efficacy objectives: comparison between experimental group and placebo group: 3.Arrhythmia requiring treatment, myocardial injury within 7 days, Efficacy objectives: comparison between experimental group and placebo group: 4.Vasoactive Inotropic Score (VIS) between day 0 (D0) and 7 (D7), Efficacy objectives: comparison between experimental group and placebo group: 5.Renal replacement therapy free days, vasopressor free days ventilator free days at D30 and D90, Efficacy objectives: comparison between experimental group and placebo group: 6.Length of stay (days) in intensive care unit (ICU), Efficacy objectives: comparison between experimental group and placebo group: 7.Length of stay (days) until discharge from hospital, Safety objectives: 8.Number of serious adverse events according to the MedDRA classification in both groups

Source: https://euclinicaltrials.eu/ctis-public/view/2024-516639-28-00